EU clinical trial 2024-515602-34-01: Ultrasound-guided Radiofrequency Ablation versus radioactive Iodine as treatment for Hyperthyroidism caused by Solitary Autonomous Thyroid Nodules (RABITO study)
Protocol code: NL77101.091.21
Sponsor: Rijnstate Ziekenhuis Stichting (Hospital/Clinic/Other health care facility). Phase: Phase III and phase IV (Integrated). Countries: Netherlands (authorised, recruitment pending).
Therapeutic area(s): Diseases [C] - Hormonal diseases [C19]
Gender: Female, Male. Age: 18-64 years, 65+ years. Enrolment: 232.
Status: Authorised, recruitment pending. Decision date: 2025-01-17. Results received: No. Last updated: 2025-01-17.

Condition(s): Hyperactive thyroid nodules
Product: SODIUM IODIDE (131I), Sodium Iodide (131I) Diagnostic Capsules 0.329 to 3.7 MBq capsules, hard

Primary endpoint: Cumulative incidence of irreversible hypothyroidism in the first year after intervention. Irreversible primary hypothyroidism is defined as: 1) (A)symptomatic elevation of TSH levels in the range of 5 - 10 mU/L for at least 10-12 weeks and without signs of recovery, confirmed by repeated measurements; or as (a)symptomatic hypothyroidism with TSH levels > 10 mU/L for more than 4 weeks, without signs of recovery, confirmed on at least two separate occasions.
Endpoint(s): Cure rate at 1 year, complete cure is defined as a normalization of TSH, FT4 and FT3 /T3levels., Thyroid nodule volume assessed by ultrasound at baseline, 6, and 12 months., Fractional nodal uptake assessed by I-123 or I-131 scintigraphy, at baseline and 12 months., Thyroid antibodies at 0 and 12 months, to monitor treatment-related autoimmunity., Treatment related adverse events, number of adverse and serious adverse events at 6 weeks, and 3, 6 and 12 months., Thyroid related quality of life, assessed by ThyPro questionnaire at baseline, and 6 and 12 months after treatment., Health outcomes and quality of life at one year, based on the European QoL-5 Dimensions (EQ-5D-5L) questionnaire, Use of health care resources during the first year after treatment, according to medical records, iMCQ and iPCQ., Cumulative costs at 1 year, Cost-effectiveness at 1 year is determined as the incremental costs in Euros per quality adjusted life year (QALY), assessed by the European QoL-5 Dimensions (EQ-5D-5L) at baseline and 6 weeks, 3, 6, 9 and 12 months after treatment and use of health care resources during the first 12 months, Course of thyroid function as assessed by TSH, FT4 and FT3 at baseline and during a one year follow-up with an extension of follow-up up to 5 years, Short-term patient satisfaction assessed by interviews, a satisfaction questionnaire, pain scoring by visual analog scale (VAS).

Source: https://euclinicaltrials.eu/ctis-public/view/2024-515602-34-01